EU clinical trial 2024-511708-18-00: KontRASt-06: An open-label phase II trial evaluating the activity and safety of JDQ443 single-agent as first-line treatment for patients with locally advanced or metastatic KRAS G12C-mutated non-small cell lung cancer with a PD-L1 expression < 1% or a PD-L1 expression ≥ 1% and an STK11 co-mutation.
Protocol code: CJDQ443B12201
Sponsor: Novartis Pharma AG (Pharmaceutical company). Phase: Therapeutic exploratory (Phase II). Countries: Netherlands (ended), Hungary (ended), Germany (ended), Belgium (temporarily halted), France (temporarily halted), Spain (temporarily halted), Portugal (ended), Greece (ended), Italy (ended), Austria (ended).
Therapeutic area(s): Diseases [C] - Neoplasms [C04]
Gender: Female, Male. Age: 18-64 years, 65+ years. Enrolment: 57.
Start date (EU): 2022-12-06. Decision date: 2024-08-27. Results received: No. Last updated: 2026-07-31.
Decision dates by country: PT: 2024-08-29, GR: 2024-11-13, NL: 2024-08-27, IT: 2024-10-09, HU: 2024-08-27, AT: 2024-10-14, FR: 2024-09-23, BE: 2024-09-02, DE: 2024-08-30, ES: 2024-08-27

Condition(s): Locally advanced or metastatic KRAS G12C-mutated non-small cell lung cancer with a PD-L1 expression < 1% or a PD-L1 expression ≥ 1% and an STK11 co-mutation.
Product: JDQ443

Primary endpoint: Overall response rate (ORR), defined as the proportion of participants with a confirmed complete response (CR) or partial response (PR) as best overall response (BOR) per Response Evaluation Criteria in Solid Tumors version 1.1 (RECIST 1.1) as determined by the investigator.
Endpoint(s): ORR per RECIST 1.1 as determined by the investigator, Type, frequency and severity of adverse events, changes in laboratory values, vital signs, electrocardiograms (ECGs)., Concentration of JDQ443 in plasma and derived PK parameters, as appropriate

Source: https://euclinicaltrials.eu/ctis-public/view/2024-511708-18-00